EU clinical trial 2023-510275-64-00: An Open-Label Study of E7386 in Combination With Other Anticancer Drug(s) in Subjects With Solid Tumors
Protocol code: E7386-J081-102
Sponsor: Eisai Limited (Pharmaceutical company). Phase: Phase I and Phase II (Integrated)- Other. Countries: France (ongoing, recruitment ended), Denmark (authorised, recruiting), Italy (ongoing, recruitment ended), Spain (ongoing, recruitment ended).
Therapeutic area(s): Diseases [C] - Neoplasms [C04]
Gender: Female, Male. Age: 18-64 years, 65+ years. Enrolment: 83.
Start date (EU): 2023-05-31. Decision date: 2024-02-12. Results received: No. Last updated: 2026-05-18.
Decision dates by country: DK: 2025-04-04, ES: 2025-04-07, IT: 2025-03-17, FR: 2024-02-12

Condition(s): Hepatocellular carcinoma, colorectal cancer, endometrial cancer, or other solid tumor
Product: E7386, Doxorubicin EBEWE 2 mg/ml koncentratas infuziniam tirpalui, E7386, Паклитаксел Ебеве 6 mg/ml концентрат за инфузионен разтвор, Paclitaxel Aurobindo 6 mg/ml concentrato per soluzione per infusione, Doxorubicina Aurobindo 2 mg/ml concentrato per soluzione per infusione, LENVIMA 10 mg hard capsules, LENVIMA 4 mg hard capsules

Primary endpoint: Safety related endpoints including DLT and/or defining the RP2D ORR defined as the proportion of subjects who have BOR of confirmed CR or PR per RECIST 1.1 by investigator assessment (Dose Optimization Parts only)
Endpoint(s): PK profile of study drug(s), BOR, ORR (Dose Escalation and Dose Expansion Parts), DCR: defined as the proportion of subjects who have a BOR of CR or PR, or SD, CBR: defined as the proportion of subjects who have a BOR of CR or PR, or durable SD, PFS: defined as the time from the first dose of study drug to the first documentation of PD or death due to any cause (whichever occurs first), OS (all subparts in Expansion and Dose Optimization Part and HCC Subparts in Dose Escalation Part): defined as the time from the first dose of study drug to death due to any cause, DOR: among subjects with PR or CR, defined as the time from the first documentation of PR or CR to the first documentation of PD or death due to any cause (whichever occurs first)

Source: https://euclinicaltrials.eu/ctis-public/view/2023-510275-64-00